EU clinical trial 2024-518622-32-00: ESONIA - The evaluation of efficacy and safety of Nebivolol in the treatment of arterial hypertension in adolescents.
Protocol code: ESONIA
Sponsor: Medical University Of Warsaw (Educational Institution). Phase: Therapeutic confirmatory (Phase III). Countries: Poland (ended).
Therapeutic area(s): Diseases [C] - Cardiovascular Diseases [C14]
Gender: Female, Male. Age: 0-17 years. Enrolment: 150.
Status: Ended. Start date (EU): 2022-07-21. End date (EU): 2026-01-31. Decision date: 2024-12-02. Results received: No. Last updated: 2024-12-02.

Condition(s): Tensile hypertension (HF) occurs in adolescents with a frequency of 10-13%. Subclinical organ lesions (left ventricular hypertrophy, microalbuminuria, hypertensive changes at the fundus of the eyes, changes in the taffin) are found in half of these patients at the time of diagnosis of hypertension and hypertension in the second decade of life is a significant risk factor for liver problems, strokes and renal failure in adulthood .
Product: Nebilenin, 5 mg, tabletki, NEBIVOLOL HYDROCHLORIDE

Primary endpoint: Number of patients whose blood pressure normalised arterial disease assessed in an office measurement at the end of the second study period (week 6) in each group (A-B), Number of patients whose blood pressure normalised arterial disease assessed by office measurement in the Ill study period (week 38), the number of patients with adverse events and serious adverse events at the end of Study Period II in each group (A-B)., the number of patients who had adverse events and serious adverse events during the Ill study period.
Endpoint(s): Number of patients whose blood pressure normalised in ABPM at the end of Study Period II (week 6) in each group (A-B) and in Ill Period in all patients (week 38), change in mean and percentile (Z-score) of systolic, diastolic and mean blood pressure assessed in the office measurement and in the ABPM study in the II study period (6 weeks) in each group (A-B) and in the Ill study period (38 weeks) in the study group, Number of patients who achieved normalization of blood pressure as measured at home (HBPM) during the last week of the II study period in each group (A-B) and at the last week of the Ill study period in all patients (week 38)

Source: https://euclinicaltrials.eu/ctis-public/view/2024-518622-32-00